EU clinical trial 2024-511030-12-00: Study of Repotrectinib and CYP450 probe Cocktail in Patients with locally advanced or Metastatic Tyrosine Kinase Inhibitors (TKI)-Pretreated ROS1-Positive Non-small Cell Lung Cancer (NSCLC)
Protocol code: CA127-1027
Sponsor: Bristol-Myers Squibb Services Unlimited Company (Pharmaceutical company). Phase: Human Pharmacology (Phase I)- Other. Countries: France (not authorised), Spain (ended), Italy (ended).
Therapeutic area(s): Diseases [C] - Neoplasms [C04]
Gender: Female, Male. Age: 18-64 years, 65+ years. Enrolment: 17.
Status: Ended. Start date (EU): 2025-02-03. End date (EU): 2025-02-20. Decision date: 2024-11-27. Results received: No. Last updated: 2025-01-29.
Decision dates by country: FR: 2024-11-27, IT: 2024-12-02, ES: 2024-12-03

Condition(s): Non-small Cell Lung Cancer (NSCLC)

Source: https://euclinicaltrials.eu/ctis-public/view/2024-511030-12-00